EU clinical trial 2023-506618-29-00: An Open-Label, Multicenter, Long-term Treatment Extension Study in Subjects Who Have Completed a Prior GlaxoSmithKline/TESARO-Sponsored Niraparib Study and are Judged by the Investigator to Benefit from Continued Treatment with Niraparib
Protocol code: 213409
Sponsor: Glaxosmithkline Research & Development Limited (Pharmaceutical company). Phase: Therapeutic exploratory (Phase II). Countries: France (ended), Italy (ongoing, recruiting), Austria (ongoing, recruiting), Spain (ongoing, recruiting), Romania (authorised, recruitment pending), Germany (authorised, recruitment pending).
Therapeutic area(s): Diseases [C] - Neoplasms [C04]
Gender: Female, Male. Age: 18-64 years, 65+ years. Enrolment: 10.
Start date (EU): 2021-09-22. Decision date: 2023-09-26. Results received: No. Last updated: 2026-02-02.
Decision dates by country: AT: 2023-10-02, FR: 2023-09-28, IT: 2023-09-29, ES: 2023-09-26, RO: 2026-02-02, DE: 2026-02-02

Condition(s): Advanced ovarian, breast, or prostate cancer
Product: Zejula 100 mg hard capsules, Zejula 100 mg film-coated tablets, Zejula 100 mg hard capsules, Zejula 100 mg film-coated tablets, Zejula 100 mg hard capsules

Primary endpoint: 1. Safety will be evaluated based on the incidence of treatment emergent AEs (TEAEs; including treatment discontinuation and dose modifications due to AEs), SAEs, AESIs, changes in ECOG performance status, changes in clinical laboratory assessments (hematology, chemistry), vital sign measurements, observations during physical examination, and use of concomitant medications (...)., 2. (excluding any study drugs used in the parent study) All AEs will be coded using the Medical Dictionary for Regulatory Activities (MedRA) coding system outlined in the statistical analysis plan.

Source: https://euclinicaltrials.eu/ctis-public/view/2023-506618-29-00